EU clinical trial 2025-524320-21-00: Prehospital pulse-dose glucocorticoid in patients with STEMI – the PULSE-MI 2 trial
Sponsor: Rigshospitalet (Hospital/Clinic/Other health care facility). Phase: Therapeutic confirmatory (Phase III). Countries: Denmark (ongoing, recruiting).
Therapeutic area(s): Diseases [C] - Cardiovascular Diseases [C14]
Gender: Female, Male. Age: 18-64 years, 65+ years. Enrolment: 5204.
Status: Ongoing, recruiting. Start date (EU): 2026-04-20. Decision date: 2026-03-11. Results received: No. Last updated: 2026-06-12.

Condition(s): ST-segment Elevation Myocardial Infarction
Product: Natriumchlorid ”Noridem”,solvens til parenteral anvendelse/injektionsvæske, opløsning, SOLU-MEDROL 125 mg pulver och vätska till injektionsvätska, lösning

Primary endpoint: All-cause mortality
Endpoint(s): Cardiovascular mortality, Spontaneous myocardial infarction, Admission for heart failure, All-cause mortality or admission for heart failure, Cardiovascular mortality or admission for heart failure, Recurrent non-fatal cardiovascular events (spontaneous myocardial infarction and admission for heart failure) with death treated as a terminal event

Source: https://euclinicaltrials.eu/ctis-public/view/2025-524320-21-00